EU clinical trial 2024-517561-16-00: A multicenter phase II study of neoadjuvant sacituzumab govitecan plus zimberelimab followed by adjuvant zimberelimab with or without sacituzumab govitecan in patients with resectable non-small cell lung cancer (NeoTRACE) [without IMPD-Q]
Protocol code: AIO-TRK/YMO-0224
Sponsor: AIO-Studien gGmbH (Laboratory/Research/Testing facility). Phase: Therapeutic exploratory (Phase II). Countries: Germany (authorised, recruitment pending).
Therapeutic area(s): Diseases [C] - Neoplasms [C04]
Gender: Female, Male. Age: 18-64 years, 65+ years. Enrolment: 50.
Status: Authorised, recruitment pending. Decision date: 2025-09-22. Results received: No. Last updated: 2026-01-16.

Condition(s): non-small cell lung cancer
Product: Zimberelimab, Trodelvy 200 mg powder for concentrate for solution for infusion

Primary endpoint: Pathological complete response (pCR) rate in the resected primary tumor and all resected lymph nodes, defined as the proportion of patients whose resected samples are negative for residual viable tumor cells
Endpoint(s): Major pathological response (MPR) rate in the resected primary tumor and all resected lymph nodes (defined as the proportion of patients whose resected samples show 10% or less residual viable tumor cells), Objective response rate (ORR) following completion of neoadjuvant therapy assessed by imaging using RECIST 1.1. Surgical resection rate. Time to surgery following C4D1, Disease-free survival, DFS (inclusion to any recurrence of disease or death from any cause in the intent-to-treat population), Overall survival, OS (inclusion to death from any cause in the intent-to-treat population). Adverse events, AE (CTCAE 5), Quality of life, QoL (EORTC-QLQ-C30 and EQ-5D-5L)

Source: https://euclinicaltrials.eu/ctis-public/view/2024-517561-16-00